EU clinical trial 2022-502817-27-00: A Phase 1b Study to Characterize the Safety and Tolerability of TEV-53408 in Adults with Celiac Disease
Protocol code: TV53408-IMM-10197
Sponsor: Teva Branded Pharmaceutical Products R&D LLC (Pharmaceutical company). Phase: Human Pharmacology (Phase I)- Other. Countries: Finland (ended).
Therapeutic area(s): Diseases [C] - Digestive System Diseases [C06]
Gender: Female, Male. Age: 18-64 years, 65+ years. Enrolment: 6.
Status: Ended. Start date (EU): 2024-03-15. End date (EU): 2025-10-08. End date: 2025-10-09. Decision date: 2023-10-19. Results received: No. Last updated: 2025-09-10.

Condition(s): Celiac disease

Source: https://euclinicaltrials.eu/ctis-public/view/2022-502817-27-00